EU clinical trial 2024-515805-25-00: Optimalization Of The Time And Dosage Of Vemurafenib In BRAF Positive Juvenile Patients With Refractory Histiocytosis
Protocol code: BRAVO
Sponsor: Instytut Matki I Dziecka (Hospital/Clinic/Other health care facility). Phase: Therapeutic exploratory (Phase II). Countries: Poland (ongoing, recruiting).
Therapeutic area(s): Diseases [C] - Neoplasms [C04]
Gender: Female, Male. Age: 0-17 years. Enrolment: 25.
Status: Ongoing, recruiting. Start date (EU): 2021-05-13. Decision date: 2024-08-26. Results received: No. Last updated: 2025-10-30.

Condition(s): histiocytic cell proliferation
Product: VEMURAFENIB

Primary endpoint: EFS – (event-free survival)., Assessment of the safety of vemurafenib treatment by AE analysis including adverse events of a special interest., Assessment of the safety of vemurafenib treatment by vital signs, laboratory tests, echocardiography and ECG findings analysis., To determine dose of the investigated substance in patient below 18 y.o. that provides exposition to the drug similar to exposition recommended in adults.
Endpoint(s): PFS (Progression-Free Survival), OS (Overall Survival), ORR (Overall Response Rate), Reactivation rate after 2 years

Source: https://euclinicaltrials.eu/ctis-public/view/2024-515805-25-00